EU clinical trial 2025-523873-41-00: A Study of Eloralintide (LY3841136) in Participants With Overweight or Obesity
Protocol code: J3R-MC-YDAK
Sponsor: Eli Lilly & Co. (Pharmaceutical company). Phase: Human Pharmacology (Phase I)- Other. Countries: Germany (ongoing, recruiting).
Therapeutic area(s): Diseases [C] - Nutritional and Metabolic Diseases [C18]
Gender: Female, Male. Age: 18-64 years, 65+ years. Enrolment: 115.
Status: Ongoing, recruiting. Start date (EU): 2026-06-09. Decision date: 2026-05-29. Results received: No. Last updated: 2026-06-22.

Condition(s): Overweight Obesity

Source: https://euclinicaltrials.eu/ctis-public/view/2025-523873-41-00